EU clinical trial 2023-509907-34-01: The efficacy and Safety of Intravenous thrombolysis in acute ischemic stroke patients with recent ingestion of Factor Xa-inhibitors Trial (SIFT)
Protocol code: SIFT
Sponsor: Oslo University Hospital HF (Hospital/Clinic/Other health care facility). Phase: Therapeutic confirmatory (Phase III). Countries: Norway (ongoing, recruiting), Denmark (authorised, recruitment pending), Sweden (authorised, recruitment pending).
Therapeutic area(s): Diseases [C] - Nervous System Diseases [C10]
Gender: Female, Male. Age: 18-64 years, 65+ years. Enrolment: 500.
Start date (EU): 2025-03-10. Decision date: 2025-01-23. Results received: No. Last updated: 2026-03-18.
Decision dates by country: NO: 2025-01-23, DK: 2026-03-18, SE: 2026-03-02

Condition(s): acute ischemic stroke
Product: RIVAROXABAN, EDOXABAN, ALTEPLASE, TENECTEPLASE, APIXABAN

Primary endpoint: Early neurological improvement, defined as a reduction of ≥8 points on the National Institutes of Health Stroke Scale (NIHSS), or NIHSS of 0-1 at 24 hours ± 12.
Endpoint(s): Percentage change in NIHSS from baseline to 24 h ± 12 h., Percent change in infarct volume at 24 h ± 12 hours., Proportion of patients: - obtaining a good functional outcome (mRS 0-2) at day 90 (+/- 2weeks); obtaining an excellent functional outcome (mRS 0-1) at day 90 (+/- 2 weeks); mRS category at day 90 (+/- 2 weeks)., Occurrence of sICH on CT/MRI within 36 hours post IVT causally related to an increase of 4 points or more on the NIHSS., Any ICH on CT/MR within 36 hours post IVT., Occurrence of death within 90 days.

Source: https://euclinicaltrials.eu/ctis-public/view/2023-509907-34-01